EU clinical trial 2022-502253-34-00: Circulating microRNAs to choose the IO strategy in PD-L1≥50% NSCLC patients: the Ark clinical trial
Sponsor: Fondazione IRCCS Istituto Nazionale Dei Tumori (Hospital/Clinic/Other health care facility). Phase: Therapeutic exploratory (Phase II). Countries: Italy (ongoing, recruiting).
Therapeutic area(s): Diseases [C] - Respiratory Tract Diseases [C08]; Diseases [C] - Neoplasms [C04]
Gender: Female, Male. Age: 18-64 years, 65+ years. Enrolment: 26.
Status: Ongoing, recruiting. Start date (EU): 2023-09-11. Decision date: 2023-05-02. Results received: No. Last updated: 2026-06-17.

Condition(s): non-small cell lung cancer
Product: Paclitaxel Mylan Generics 6 mg/ml concentrato per soluzione per infusione, Pemetrexed Mylan 25 mg/ml concentrato per soluzione per infusione, CISPLATINO SANDOZ, KEYTRUDA 25 mg/mL concentrate for solution for infusion, CARBOPLATINO TEVA 10 mg/ml concentrato per soluzione per infusione

Primary endpoint: Disease Control Rate (DCR)
Endpoint(s): Progression-Free Survival (PFS), Overall Survival (OS), Overall Response Rate (ORR), Response Duration (DoR)

Source: https://euclinicaltrials.eu/ctis-public/view/2022-502253-34-00